EU clinical trial 2024-515965-32-00: Randomised, double-blind study comparing the analgesic efficacy of a lidocaine-prilocaine combination with lidocaine alone as local anesthesia for dental procedures in participants with MC1R mutation
Protocol code: PVX 2024-01
Sponsor: Pharmavax AS (Pharmaceutical company). Phase: Therapeutic exploratory (Phase II). Countries: Norway (ended).
Therapeutic area(s): Analytical, Diagnostic and Therapeutic Techniques and Equipment [E] - Anesthesia and Analgesia [E03]
Gender: Female, Male. Age: 18-64 years, 65+ years. Enrolment: 22.
Status: Ended. Start date (EU): 2024-12-09. End date (EU): 2024-12-31. Decision date: 2024-11-27. Results received: Yes. Last updated: 2024-11-27.

Condition(s): Subjects having local anesthesia for dental procedures.
Product: Citanest® Dental Octapressin 30 mg/ml + 0,03 IE/ml, Xylocain ®Dental adrenalin 20 mg/ml + 12,5 mikrog/ml; Injeksjonsvæske, oppløsning i sylindretter

Primary endpoint: Successful pulpal anaesthesia measured by two consecutive 64/64 readings without any participant response, within 10 min with an electric pulp tester.
Endpoint(s): Successful pulpal anaesthesia measured by the participants cold sensation during an ice test applied to the treated area., Subject’s assessment of successful soft tissue anaesthesia (yes/no) during a standard pocket procedure., Participant experience of anaesthesia on a scale from 1-5.

Source: https://euclinicaltrials.eu/ctis-public/view/2024-515965-32-00